EU clinical trial 2023-507203-55-00: A three part randomized, double-blind, placebo-controlled, parallel group SAD and MD clinical study to evaluate the safety, tolerability and preliminary efficacy of an inhaled (nebulized) phage cocktail in healthy subjects and in patients with chronic colonization of the lung with Pseudomonas aeruginosa
Protocol code: Phage4Cure-001
Sponsor: Charite Research Organisation GmbH (Pharmaceutical company). Phase: Human Pharmacology (Phase I)- First administration to humans. Countries: Germany (ended).
Therapeutic area(s): Diseases [C] - Bacterial Infections and Mycoses [C01]; Diseases [C] - Respiratory Tract Diseases [C08]
Gender: Female, Male. Age: 18-64 years, 65+ years. Enrolment: 50.
Status: Ended. Start date (EU): 2023-08-21. End date (EU): 2025-05-27. Decision date: 2023-08-08. Results received: No. Last updated: 2025-05-27.

Condition(s): Pseudomonas colonization

Source: https://euclinicaltrials.eu/ctis-public/view/2023-507203-55-00